EU clinical trial 2025-521560-36-00: A Phase 2b, Randomised, Double-Blind, Placebo-Controlled, Parallel-Arm Dose Finding Study Evaluating the Efficacy and Safety of SAB-142 for Delaying the Progression of Type 1 Diabetes (T1D) in Patients with Stage 3 New Onset of Type 1 Diabetes (NOT1D)
Protocol code: SAB-142-201
Sponsor: Sab Biotherapeutics Inc. (Pharmaceutical company). Phase: Therapeutic exploratory (Phase II). Countries: Austria (ongoing, recruiting), Germany (authorised, recruiting), Poland (ongoing, recruiting), Italy (ongoing, recruiting), Denmark (ongoing, recruiting), Spain (ongoing, recruiting), Belgium (ongoing, recruiting), Finland (authorised, recruiting), France (ongoing, recruiting), Lithuania (ongoing, recruiting), Slovenia (ongoing, recruiting).
Therapeutic area(s): Diseases [C] - Nutritional and Metabolic Diseases [C18]
Gender: Female, Male. Age: 0-17 years, 18-64 years. Enrolment: 66.
Start date (EU): 2026-04-22. Decision date: 2026-02-02. Results received: No. Last updated: 2026-05-11.
Decision dates by country: FR: 2026-02-05, LT: 2026-02-06, SI: 2026-02-06, ES: 2026-02-06, DK: 2026-02-02, BE: 2026-02-02, PL: 2026-02-08, IT: 2026-02-04, DE: 2026-02-09, FI: 2026-02-04, AT: 2026-02-07

Condition(s): Type 1 Diabetes
Product: SAB-142, SODIUM CHLORIDE

Primary endpoint: Recording and reviewing any health problems or side effects that occur during the study, Checking measures of pancreas function related to insulin production
Endpoint(s): Monitoring blood sugar control, including information from continuous glucose monitoring devices

Source: https://euclinicaltrials.eu/ctis-public/view/2025-521560-36-00